EU clinical trial 2023-507641-29-00: HERTHENA-PanTumor01: A Phase 2, Multicenter, Multicohort, Open-Label, Proof of Concept Study of Patritumab Deruxtecan (HER3-DXd) in Subjects with Locally Advanced or Metastatic Solid Tumors
Protocol code: U31402-277
Sponsor: Daiichi Sankyo Inc. (Pharmaceutical company). Phase: Therapeutic exploratory (Phase II). Countries: Belgium (ongoing, recruiting), France (ongoing, recruiting), Spain (ongoing, recruiting), Germany (ongoing, recruiting), Hungary (ongoing, recruiting), Italy (ongoing, recruiting), Netherlands (ongoing, recruiting), Norway (ongoing, recruiting).
Therapeutic area(s): Diseases [C] - Neoplasms [C04]
Gender: Female, Male. Age: 18-64 years, 65+ years. Enrolment: 373.
Status: Ongoing, recruiting. Start date (EU): 2024-07-15. Decision date: 2024-05-06. Results received: No. Last updated: 2026-07-13.
Decision dates by country: HU: 2025-04-09, FR: 2024-05-14, NO: 2025-04-08, IT: 2025-04-09, BE: 2024-05-06, NL: 2025-04-11, ES: 2024-05-13, DE: 2025-03-27

Condition(s): Locally Advanced or Metastatic Solid Tumors
Product: Patritumab deruxtecan

Primary endpoint: The primary endpoint of the study is ORR as assessed by the investigator per Response Evaluation Criteria in Solid Tumors, Version 1.1 (RECIST v1.1). for all cohorts except Prostate cancer cohort, For Prostate Cohort only:The PE is PSA50. Changes in PSA have been shown to correlate with OS, and this EP will allow for timely understanding of the antitumor activity in parallel with available safety endpoints. PSA50 response rate, defined as the proportion of patients with a ≥50% decrease in PSA level from baseline to the lowest postbaseline PSA result, confirmed by a consecutive PSA assessment at least 3 weeks later has been used in other clinical studies in prostate cancer
Endpoint(s): TEAEs and other safety parameters during the study, Duration of response (DoR), Clinical benefit rate (CBR), Disease control rate (DCR), Time to response (TTR), Progression-free survival (PFS) evaluated by the investigator per RECIST v1.1, Overall survival (OS), including Prostate cancer cohort, PK endpoints, including Prostate cancer cohort, Correlation between HER3 protein expression at baseline (as determined by HER3 IHC assay) and efficacy, , including Prostate cancer cohort, For Prostate cohort only: rPFS (PCWG3), For Prostate cohort only: PSA30 response rate, For Prostate cohort only: Time to first subsequent anticancer therapy (TFST), For Prostate cohort only: Time to first symptomatic skeletal-related event (SSRE)

Source: https://euclinicaltrials.eu/ctis-public/view/2023-507641-29-00